EU clinical trial 2025-521003-52-00: C5731006 - A PHASE 1B/2, OPEN-LABEL, MULTICOHORT STUDY OF DISITAMAB VEDOTIN IN ADULTS WITH HER2 EXPRESSING ADVANCED BREAST CANCER
Protocol code: C5731006/SGNDV-006
Sponsor: Pfizer Inc. (Pharmaceutical company). Phase: Phase I and Phase II (Integrated)- Other. Countries: Germany (ongoing, recruiting), Spain (ongoing, recruiting), Italy (ongoing, recruiting).
Therapeutic area(s): Diseases [C] - Neoplasms [C04]
Gender: Female, Male. Age: 18-64 years, 65+ years. Enrolment: 26.
Status: Ongoing, recruiting. Start date (EU): 2025-12-19. Decision date: 2025-11-18. Results received: No. Last updated: 2026-04-29.
Decision dates by country: DE: 2025-11-21, IT: 2025-11-18, ES: 2025-11-24

Condition(s): HER2 Expressing Advanced Breast Cancer
Product: Disitamab Vedotin

Primary endpoint: Objective response (OR) (confirmed complete response [CR] and confirmed partial response [PR]) per Response Evaluation Criteria in Solid Tumors version 1.1 (RECIST v1.1) by investigator assessment.
Endpoint(s): Duration of response (DOR) per RECIST v1.1 by investigator assessment., Disease control rate (DCR) (confirmed CR, confirmed PR, and stable disease) per RECIST v1.1 by investigator assessment., Progression-free survival (PFS) per RECIST v1.1 by investigator assessment., Overall survival (OS)., Estimates of selected PK parameters of disitamab vedotin, total antibody, and unconjugated MMAE., Incidence of anti-drug antibodies (ADA) against disitamab vedotin., Safety (type, incidence, severity, seriousness, and relatedness of adverse events [AEs]. Type, incidence, and severity of laboratory abnormalities as well as significant changes from baseline. Frequency of treatment interruptions, dose reductions, and treatment discontinuation due to AEs).

Source: https://euclinicaltrials.eu/ctis-public/view/2025-521003-52-00